EU clinical trial 2023-510379-77-00: A study of safety and efficacy of novel targeted therapy combinations in adult patients with advanced or metastatic colorectal cancer.
Protocol code: CADPT01C12101
Sponsor: Novartis Pharma AG (Pharmaceutical company). Phase: Human Pharmacology (Phase I)- Other. Countries: Spain (ended).
Therapeutic area(s): Diseases [C] - Neoplasms [C04]
Gender: Female, Male. Age: 18-64 years, 65+ years. Enrolment: 35.
Status: Ended. Start date (EU): 2020-08-05. End date (EU): 2024-09-25. End date: 2024-09-26. Decision date: 2024-06-10. Results received: No. Last updated: 2024-06-10.

Condition(s): Advanced or metastatic BRAF V600 colorectal cancer.

Source: https://euclinicaltrials.eu/ctis-public/view/2023-510379-77-00